EU clinical trial 2024-515912-27-00: A single-arm extension study to investigate the long-term safety, tolerability, and efficacy of lunsekimig in adult participants with inadequately controlled chronic rhinosinusitis with nasal polyps (CRSwNP) who completed a previous lunsekimig CRSwNP clinical study
Protocol code: LTS18300
Sponsor: Sanofi-Aventis Recherche & Developpement (Pharmaceutical company). Phase: Therapeutic exploratory (Phase II). Countries: Bulgaria (ongoing, recruitment ended), Poland (ongoing, recruitment ended), Belgium (ongoing, recruitment ended).
Therapeutic area(s): Diseases [C] - Respiratory Tract Diseases [C08]
Gender: Female, Male. Age: 18-64 years, 65+ years. Enrolment: 40.
Status: Ongoing, recruitment ended. Start date (EU): 2025-12-08. Decision date: 2025-06-11. Results received: No. Last updated: 2026-06-22.
Decision dates by country: BE: 2025-06-11, PL: 2025-06-16, BG: 2025-06-13

Condition(s): Chronic rhinosinusitis with nasal polyps
Product: SAR443765 / LUNSEKIMIG

Primary endpoint: Incidence of participants with treatment-emergent adverse events (TEAEs) including adverse events of special interest (AESI), and serious adverse events (SAEs)
Endpoint(s): Change in SNOT-22 total score, Change in rhinosinusitis visual analog scale (VAS), Change in University of Pennsylvania Smell Identification Test (UPSIT) score, Serum lunsekimig concentrations, Anti-drug antibodies (ADA) against lunsekimig

Source: https://euclinicaltrials.eu/ctis-public/view/2024-515912-27-00